EU clinical trial 2023-508363-79-00: A First-in-Human Study to Evaluate the Safety and Tolerability of ALN-APP in Patients with EOAD
Protocol code: ALN-APP-001
Sponsor: Alnylam Pharmaceuticals Inc. (Pharmaceutical company). Phase: Human Pharmacology (Phase I)- First administration to humans. Countries: Netherlands (ongoing, recruiting).
Therapeutic area(s): Diseases [C] - Nervous System Diseases [C10]
Gender: Female, Male. Age: 18-64 years, 65+ years. Enrolment: 6.
Status: Ongoing, recruiting. Start date (EU): 2022-06-29. Decision date: 2024-02-05. Results received: No. Last updated: 2026-03-05.

Condition(s): Early-onset Alzheimer's disease (EOAD)

Source: https://euclinicaltrials.eu/ctis-public/view/2023-508363-79-00